EU clinical trial 2024-520073-13-00: Bisphosphonate vs. Placebo Prior to Parathyroidectomy in Primary Hyperparathyroidisme: A Randomized, blinded Placebo-controlled Trial
Protocol code: 2023-000007-39
Sponsor: Region Midtjylland (Hospital/Clinic/Other health care facility). Phase: Phase III and phase IV (Integrated). Countries: Denmark (ongoing, recruiting).
Therapeutic area(s): Diseases [C] - Musculoskeletal Diseases [C05]
Gender: Female, Male. Age: 18-64 years, 65+ years. Enrolment: 140.
Status: Ongoing, recruiting. Start date (EU): 2025-03-02. Decision date: 2025-01-02. Results received: No. Last updated: 2026-02-02.

Condition(s): Primary hyperparathyroidism
Product: Zoledronic Acid Oresund Pharma 4 mg/100 ml infusionsvätska, lösning, SODIUM CHLORIDE

Primary endpoint: Effects of ZOL vs. placebo at time of parathyroidectomy on aBMD at lumbar spine, one year after PTX.
Endpoint(s): Effects on aBMD at distal forearm, femoral neck, and total hip, Effects on microarchitecture measured by high-resolution peripheral computed tomography (HRpQCT), Effects on biochemical bone turnover markers (BTM)., Effects on vBMD at the hip and lumbar spine., Effects on CACS., Effects on PWV., Effects on renal calcifications and urinary analytes.

Source: https://euclinicaltrials.eu/ctis-public/view/2024-520073-13-00